EU clinical trial 2023-508636-61-00: A Phase 3, Randomized, Double-Blind, Placebo-Controlled Program to Evaluate the Efficacy and Safety of Tulisokibart in Participants with Moderately to Severely Active Crohn’s Disease
Protocol code: MK-7240-008
Sponsor: Merck Sharp & Dohme LLC (Pharmaceutical company). Phase: Therapeutic confirmatory (Phase III). Countries: Spain (ongoing, recruitment ended), Netherlands (ongoing, recruitment ended), Italy (ongoing, recruitment ended), Portugal (ongoing, recruitment ended), Germany (ongoing, recruitment ended), Romania (ongoing, recruitment ended), Austria (ongoing, recruitment ended), France (ongoing, recruitment ended), Finland (ongoing, recruitment ended), Croatia (ongoing, recruitment ended), Hungary (ongoing, recruitment ended), Sweden (ongoing, recruitment ended), Greece (ongoing, recruitment ended), Slovakia (ongoing, recruitment ended), Poland (ongoing, recruitment ended), Belgium (ongoing, recruitment ended), Czechia (ongoing, recruitment ended), Denmark (ongoing, recruitment ended), Ireland (ended), Latvia (ongoing, recruitment ended), Lithuania (ongoing, recruitment ended).
Therapeutic area(s): Diseases [C] - Digestive System Diseases [C06]
Gender: Female, Male. Age: 18-64 years, 65+ years. Enrolment: 572.
Start date (EU): 2024-10-24. Decision date: 2024-10-21. Results received: No. Last updated: 2026-07-20.
Decision dates by country: HU: 2024-10-28, NL: 2024-10-23, IT: 2024-10-22, LV: 2025-02-12, DE: 2024-10-25, HR: 2024-10-28, PT: 2024-10-24, BE: 2025-01-16, SK: 2025-01-23, SE: 2024-12-11, PL: 2025-01-21, IE: 2025-02-14, AT: 2024-10-28, RO: 2024-10-28, FR: 2024-10-22, DK: 2025-02-06, LT: 2025-02-10, GR: 2025-01-09, CZ: 2025-03-10, ES: 2024-10-21, FI: 2024-10-28

Condition(s): Crohn’s Disease
Product: tulisokibart, Placebo to Subcutaneous or intravenous MK-7240 (Tulisokibart), tulisokibart

Primary endpoint: Study 1 [US/FDA]: Percentage of Participants Achieving Clinical Remission per Crohn’s Disease Activity Index (CDAI) Score at Week 52, Study 1 [EU/EMA Only]: Percentage of Participants Achieving Clinical Remission per Stool Frequency and Abdominal Pain Score at Week 52, Study 1: Percentage of Participants Achieving Endoscopic Response at Week 52, Study 1 [US/FDA only]: Percentage of Participants Achieving Clinical Remission per CDAI Score at Week 12, Study 1 [EU/EMA Only]: Percentage of Participants Achieving Clinical Remission per Stool Frequency and Abdominal Pain Score at Week 12, Study 1: Percentage of Participants Achieving Endoscopic Response at Week 12
Endpoint(s): Study 1: Number of Participants Who Experienced an Adverse Event (AE), Study 1: Number of Participants who Discontinue Study Intervention due to an AE, Study 1 [US/FDA Only]: Percentage of Participants Achieving Clinical Remission per Stool Frequency and Abdominal Pain Score at Week 12, Study 1 [EU/EMA Only]: Percentage of Participants Achieving Clinical Remission per CDAI Score at Week 12, Study 1: Percentage of Participants with Decrease of ≥100 Points in CDAI Score from Baseline to Week 12, Study 1: Mean Change from Baseline in Functional Assessment of Chronic Illness Therapy – Fatigue (FACIT-Fatigue) Score at Week 12, Study 1: Percentage of Participants Achieving Endoscopic Remission at Week 12, Study 1: Percentage of Participants in Diagnostic Assay Positive (Dx+) Subpopulation Achieving Clinical Remission per CDAI at Week 12, Study 1: Percentage of Participants in Diagnostic Assay Positive (Dx+) Subpopulation Achieving Endoscopic Response at Week 12, Study 1: Percentage of Participants Achieving Clinical Remission per Stool Frequency and Abdominal Pain Score at Week 52, Study 1: Percentage of Participants Achieving Clinical Remission per CDAI Score at Week 52, Study 1: Percentage of Participants with Decrease of ≥100 Points in CDAI Score from Baseline to Week 52, Study 1: Percentage of Participants Achieving Endoscopic Remission at Week 52, Study 1: Percentage of Participants Achieving Sustained Clinical Remission per CDAI at Week 12 and Week 52, Study 1 [US/FDA]:: Percentage of Participants Achieving Corticosteroid-Free Clinical Remission per CDAI Score at Week 52, Study 1 [EU/EMA]: Percentage of Participants Achieving Corticosteroid-Free Clinical Remission per Stool Frequency and Abdominal Pain Score at Week 52, Study 1: Percentage of Participants Achieving Clinical Remission per Stool Frequency, Abdominal Pain Score, and Endoscopic Remission at Week 52, Study 1: Percentage of Participants Achieving Clinical Remission per CDAI and Endoscopic Remission at Week 52, Study 1: Mean Change from Baseline in FACIT-Fatigue Score at Week 52, Study 1: Mean Change from Baseline in Inflammatory Bowel Disease Questionnaire (IBDQ) Score at Week 52, Study 1: Percentage of Participants with Ulcer-Free Endoscopy at Week 52

Source: https://euclinicaltrials.eu/ctis-public/view/2023-508636-61-00